EU clinical trial 2024-512133-33-00: The prevention of systemic ectopic mineralization in pseudoxanthoma elasticum - TEMP-PREVENT trial - (Treatment of Ectopic Mineralization in Pseudoxanthoma elasticum) A placebo controlled, double-blind randomized trial evalueating the effect of etidronate in young patients with pseudoxanthoma elasticum.
Protocol code: 24U-1056
Sponsor: Universitair Medisch Centrum Utrecht (Hospital/Clinic/Other health care facility). Phase: Therapeutic confirmatory (Phase III). Countries: Netherlands (ongoing, recruitment ended).
Therapeutic area(s): Diseases [C] - Cardiovascular Diseases [C14]; Diseases [C] - Eye Diseases [C11]; Diseases [C] - Skin and Connective Tissue Diseases [C17]
Gender: Female, Male. Age: 18-64 years. Enrolment: 76.
Status: Ongoing, recruitment ended. Start date (EU): 2023-04-26. Decision date: 2024-10-28. Results received: No. Last updated: 2024-10-28.

Condition(s): Pseudoxanthoma Elasticum
Product: ETIDRONATE DISODIUM ORAL CAPSULES 400 MG

Primary endpoint: The main study endpoint will be the percentage change in arterial calcification in carotid siphon and legs measured with low-dose CT scan after 24 months of treatment with etidronate compared with placebo.
Endpoint(s): To determine the effect of 24 months of treatment with etidronate on functional ophthalmological measurements, such as visual compared to placebo., To determine if 24 months of treatment with etidronate halts the progression of normalized reflectivity in Bruch’s membrane as measured with SD-optical coherence tomography, compared to placebo., To determine the effect of 24 months of treatment with etidronate on structural ophthalmological measurements on fundus photography (infrared and autofluorescence and OCT-angiography)., 7T Magnetic resonance imaging will be used to determine if treatment with etidronate halts the progression of increased pulsatility index of the intracranial carotid arteries and middle cerebral arteries., To determine if treatment with etidronate halts the progression of elastin degradation and of calcification in the skin in skin biopsies, compared to placebo., To determine if treatment with etidronate leads to increased levels of plasma levels of inorganic pyrophosphate compared to placebo., To determine if treatment with etidronate halts the progression of systemic elastin degradation products, as measured via plasma levels of desmosin, compared to placebo., To determine if treatment with etidronate halts the progression of arterial calcification in legs and siphons, as measured with computed tomography, compared to placebo., To determine if treatment with etidronate halts the progression of increased carotid intima media thickness, as measured with ultrasound with a linear array transducer, compared to placebo., To determine if treatment with etidronate halts the progression of arterial stiffness, as measured by pulse wave analysis and velocity using a Doppler-ultrasound, compared to placebo., To determine if treatment with etidronate halts progression of peripheral artery disease measured by the ankle brachial index, the WELCH questionnaire and the six-minute walking test., To determine if treatment with etidronate leads to decreased occurrence of major cardiovascular events (stroke, TIA, myocardial infarction or cardiovascular death) events compared to placebo., To determine if treatment with etidronate leads to improved reported quality of life and self reported health, as measured with the EQ-5D, PROMIS 10, PROMIS PF, USER P compared to placebo., To determine if 24 months of treatment with etidronate leads to better results on cognitive outcomes, compared with placebo, To determine if treatment with etidronate leads to observed differences in safety measures: changes in plasma calcium, phosphate, ASAT, ALAT, eGFR measured via laboratory assessment, and number of anti-VEGF injections used

Source: https://euclinicaltrials.eu/ctis-public/view/2024-512133-33-00